EU clinical trial 2025-521583-35-00: Hyperprogression upon cemiplimab alone or with chemotherapy in PD-L1 ≥ 50% NSCLC: a biomarker guided phase 2 trial – HYPERBOLIC study
Protocol code: Hyperbolic
Sponsor: Universita' Vita-salute S. Raffaele (Educational Institution). Phase: Therapeutic exploratory (Phase II). Countries: Italy (authorised, recruitment pending).
Therapeutic area(s): Diseases [C] - Neoplasms [C04]
Gender: Female, Male. Age: 18-64 years, 65+ years. Enrolment: 700.
Status: Authorised, recruitment pending. Decision date: 2026-02-10. Results received: No. Last updated: 2026-06-24.

Condition(s): non-small cell lung cancer (NSCLC)
Product: LIBTAYO 350 mg concentrate for solution for infusion., CARBOPLATIN, PEMETREXED, CISPLATIN, PACLITAXEL

Primary endpoint: HPD and ED rate, defined as the proportion of patients with a delta of TGR ≥50% or a TGR ratio ≥2 at 7 weeks ± 5 days from randomization or who died before with no scan performed from treatment start
Endpoint(s): (related to activity-efficacy secondary objective) HPD rate, defined as the proportion of patients with a delta of TGR ≥50% and/or a TGR ratio ≥2 at 5 weeks ± 5 days from treatment start., (related to activity-efficacy secondary objective) Objective Response Rate (ORR), defined as the percentage of patients with an objective response as determined by RECIST 1.1., (related to activity-efficacy secondary objective) Progression free survival (PFS), defined as the time from randomization to the date of first progression or death from any cause, whichever comes first. Data from patients who have not had an event at the time of data analysis will be censored on the date on which they are last known to be alive and event free., (related to activity-efficacy secondary objective) Overall survival (OS), defined as the time from randomization until the date of death from any cause. Data from patients who are still alive at the time of data analysis will be censored on the date on which they are last known to be alive., (related to safety and tolerability secondary objective) Summary of adverse events (AE), with a focus on TRAEs coded based upon the Medical Dictionary for Regulatory Activities (MedDRA) and graded based upon CTCAE, ver. 5.0., (related to exploratory objective) Characterization of clinical, radiological, and biological patients’ features correlated with HPD occurrence. - Dynamic assessment of circulating and tissue features of HPD according to treatment type (cemiplimab alone or cemiplimab + PCT) - HPD rate among patients not meeting inclusion criterion 7 (circulating CD10- LDNs >30.5% at screening).

Source: https://euclinicaltrials.eu/ctis-public/view/2025-521583-35-00